EU clinical trial 2024-520069-30-00: Effect of Exenatide on disease progression in early Parkinson’s disease.
Protocol code: Exenatide
Sponsor: Region Stockholm – SLSO (Hospital/Clinic/Other health care facility). Phase: Therapeutic exploratory (Phase II). Countries: Sweden (ended).
Therapeutic area(s): Diseases [C] - Nervous System Diseases [C10]
Gender: Female, Male. Age: 18-64 years, 65+ years. Enrolment: 60.
Status: Ended. Start date (EU): 2020-01-21. End date (EU): 2026-06-30. Decision date: 2024-12-20. Results received: No. Last updated: 2024-12-20.

Condition(s): Parkinson's disease
Product: Bydureon 2 mg powder and solvent for prolonged-release suspension for injection, Powder and solvent for prolongedrelease suspension for injection in pre-filled pen

Primary endpoint: FDG-PET network analysis at baseline, 9 and 21 months
Endpoint(s): MDS-UPDRS part 3 in OFF-medication state and accelerometer-based parameters of physical activity, MDS-UPDRS part 3 in ON-medication state, MDS-UPDRS parts 1, 2 and 4, biofluid-based parameters at baseline, 9, 18 and 21 months, LEDD at baseline, 3, 6, 9, 12, 15, 18 and 21 months, PDQ-39, NMSQuest, ESS at baseline, 6, 12, 18 months, MoCA at baseline, 9 and 21 months, B-SIT at baseline, 9 and 18 months, MADRS at screening, 6, 12 and 18 months

Source: https://euclinicaltrials.eu/ctis-public/view/2024-520069-30-00